EU clinical trial 2023-509165-21-00: The CLEAN-DUCT / TRITICC-3 trial - Phase IIa, prospective, single arm, open label, non-randomized, multi-center pilot study of durvalumab (MEDI4736) + intraductal radiofrequency ablation (ID-RFA) in extrahepatic cholangiocarcinoma
Protocol code: CLEAN-DUCT
Sponsor: Institut fuer Klinische Krebsforschung IKF GmbH (Pharmaceutical company). Phase: Therapeutic exploratory (Phase II). Countries: Germany (ongoing, recruiting).
Therapeutic area(s): Diseases [C] - Digestive System Diseases [C06]; Diseases [C] - Neoplasms [C04]
Gender: Female, Male. Age: 18-64 years, 65+ years. Enrolment: 42.
Status: Ongoing, recruiting. Start date (EU): 2024-08-08. Decision date: 2024-05-15. Results received: No. Last updated: 2026-01-16.

Condition(s): Extrahepatic cholangiocarcinoma (eCCA)
Product: CISPLATIN, IMFINZI 50 mg/mL concentrate for solution for infusion., GEMCITABINE

Primary endpoint: Overall survival rate after 12 months (OS@12)
Endpoint(s): Progression-free survival (PFS), Overall survival (OS), Safety, Time to cholangitis, Quality of life (QoL)

Source: https://euclinicaltrials.eu/ctis-public/view/2023-509165-21-00